EU clinical trial 2024-515903-21-00: Phase 1b Study of Tarlatamab in Combination with YL201 with or without Anti-PD-L1 in Subjects with Extensive Stage Small Cell Lung Cancer (DeLLphi-310)
Protocol code: 20240124
Sponsor: Amgen Inc. (Pharmaceutical company). Phase: Human Pharmacology (Phase I)- Other. Countries: France (temporarily halted), Germany (temporarily halted), Spain (temporarily halted), Greece (temporarily halted), Hungary (temporarily halted), Italy (temporarily halted).
Therapeutic area(s): Diseases [C] - Neoplasms [C04]
Gender: Female, Male. Age: 18-64 years, 65+ years. Enrolment: 47.
Status: Temporarily halted. Start date (EU): 2025-10-31. Decision date: 2025-09-30. Results received: No. Last updated: 2026-08-07.
Decision dates by country: GR: 2025-10-06, ES: 2025-10-01, IT: 2025-09-30, DE: 2025-10-01, HU: 2025-10-03, FR: 2025-09-30

Condition(s): Extensive Stage Small Cell Lung Cancer (ES-SCLC)

Source: https://euclinicaltrials.eu/ctis-public/view/2024-515903-21-00